EU clinical trial 2025-524233-45-00: A first-in-human, randomized, double-blind, placebo-controlled, 3-part study assessing the safety, tolerability, pharmacodynamics and pharmacokinetics of GL0071 after single and repeated ascending subcutaneous doses in healthy normal weight, overweight and obese participants, as well as a 12-week treatment randomized, double blind, placebo-controlled exploratory Proof-of-Concept study in overweight and obese participants.
Protocol code: SP-G0071-01
Sponsor: Sun Pharmaceutical Industries Limited (Pharmaceutical company). Phase: Human Pharmacology (Phase I)- First administration to humans. Countries: Belgium (authorised, recruitment pending).
Therapeutic area(s): Diseases [C] - Nutritional and Metabolic Diseases [C18]
Gender: Female, Male. Age: 18-64 years. Enrolment: 124.
Status: Authorised, recruitment pending. Decision date: 2026-07-27. Results received: No. Last updated: 2026-07-27.

Condition(s): Type 2 diabetes mellitus, Overweight

Source: https://euclinicaltrials.eu/ctis-public/view/2025-524233-45-00